EU clinical trial 2025-522138-29-00: A phase II, multicenter, open-label, single arm study to evaluate the safety and efficacy of asciminib in pediatric participants newly diagnosed or previously treated with Philadelphia positive Chronic Myelogenous Leukemia in Chronic Phase (Ph+ CML-CP) with or without known T315I mutation
Protocol code: CABL001I12202
Sponsor: Novartis Pharma AG (Pharmaceutical company). Phase: Therapeutic exploratory (Phase II). Countries: Spain (ongoing, recruiting), France (ongoing, recruiting), Germany (authorised, recruitment pending), Poland (authorised, recruitment pending), Italy (ongoing, recruiting), Netherlands (authorised, recruitment pending), Greece (authorised, recruitment pending).
Therapeutic area(s): Diseases [C] - Neoplasms [C04]
Gender: Female, Male. Age: 0-17 years. Enrolment: 15.
Start date (EU): 2026-06-18. Decision date: 2026-05-18. Results received: No. Last updated: 2026-07-30.
Decision dates by country: FR: 2026-05-26, NL: 2026-05-18, PL: 2026-05-25, ES: 2026-05-19, IT: 2026-05-21, DE: 2026-05-19, GR: 2026-07-30

Condition(s): Philadelphia positive Chronic Myeloid leukemia in Chronic Phase with newly diagnosed and resistant/intolerant to previous TKIs, with or without the T315I mutation
Product: Asciminib, ASCIMINIB HYDROCHLORIDE

Primary endpoint: Major Molecular Response (MMR) at Week 48
Endpoint(s): • MMR at Week 96 • MMR at and by scheduled timepoints, • Hematologic, cytogenetic and other molecular responses (MRs) at and by scheduled timepoints • Time to response and duration of response (limited to the binary response endpoints), time to treatment failure, time to disease progression, event free survival, overall survival, • Incidence of treatment-emergent adverse events (TEAEs) and other safety data as considered appropriate, • Height/length, weight, bone age measured by X-Ray, Tanner staging, • PK parameters of asciminib: AUClast, AUCtau, Cmax, Tmax, Ctrough

Source: https://euclinicaltrials.eu/ctis-public/view/2025-522138-29-00